EU clinical trial 2025-520969-51-00: Effects of sodium-glucose cotransporter 2 inhibition on the mechanisms of heart failure with preserved ejection fraction
Protocol code: FIBHGM-ECNC001-2019
Sponsor: Fundación para la Innovación en Biomedicina, Fundacion Para La Investigacion Biomedica Del Hospital Gregorio Maranon (SME, Hospital/Clinic/Other health care facility). Phase: Therapeutic use (Phase IV). Countries: Spain (authorised, recruitment pending).
Therapeutic area(s): Diseases [C] - Cardiovascular Diseases [C14]
Gender: Female, Male. Age: 18-64 years, 65+ years. Enrolment: 20.
Status: Authorised, recruitment pending. Decision date: 2025-01-31. Results received: No. Last updated: 2025-01-31.

Condition(s): Heart failure with preserved ejection fraction
Product: Forxiga 10 mg film-coated tablets

Primary endpoint: Systolic properties derived from PV curve analysis: Maximum elastance, Diastolic properties derived from PV curve analysis: Relaxation, stiffness, equilibrium volume, elastic recoil
Endpoint(s): Reverse geometric remodeling variables of the LV: Ventricular volumes and mass measured by cardiac magnetic resonance imaging (MRI), Intraventricular flow patterns based on Doppler echocardiography and phase-contrast MRI: Vorticity parameters and blood transport into the LV; energy exchange between the myocardium and blood, Cardiomyocyte alterations: grade of hypertrophy assessed by morphometry and expression of pro-hypertrophic genes (atrial natriuretic peptide, sarcomeric proteins using real-time RT-PCR and western blot), Interstitial and perivascular fibrosis, Degree of collagen crosslinking, Microvascular alterations, Cardiomyocyte stiffness: Titin, Extracellular matrix: Lysyl-oxidases and hydroxylases, miR-19b, WISPER, and AGEs, Cardiomyocytes: NT-proBNP, high-sensitivity troponin T (TnT)

Source: https://euclinicaltrials.eu/ctis-public/view/2025-520969-51-00